EU clinical trial 2025-523543-36-00: Study on the influence of FLUMAzenil regarding the incidence of pediatric emergence delirium (ED) in children undergoing ENT surgery – FLUMA Study
Protocol code: FLUMA-Study
Sponsor: Rheinische Friedrich-Wilhelms-Universitaet Bonn (Educational Institution). Phase: Phase III and phase IV (Integrated). Countries: Germany (ongoing, recruiting).
Therapeutic area(s): Not possible to specify
Gender: Female, Male. Age: 0-17 years. Enrolment: 1.
Status: Ongoing, recruiting. Start date (EU): 2026-05-18. Decision date: 2026-01-23. Results received: No. Last updated: 2026-02-11.

Condition(s): pediatric emergence delirium
Product: SODIUM CHLORIDE, Flumazenil B. Braun 0,1 mg/ml Injektionslösung und Konzentrat zur Herstellung einer Infusionslösung

Primary endpoint: The occurrence of postoperative delirium (pädED) until discharge from the recovery room. A score of ≥ 10 points is indicative of delirium.

Source: https://euclinicaltrials.eu/ctis-public/view/2025-523543-36-00